EU clinical trial 2023-503568-18-00: A PHASE III, RANDOMIZED, DOUBLE-BLIND, PLACEBO-CONTROLLED CLINICAL TRIAL TO EVALUATE THE EFFICACY AND SAFETY OF ADJUVANT ATEZOLIZUMAB OR PLACEBO AND TRASTUZUMAB EMTANSINE FOR HER2-POSITIVE BREAST CANCER AT HIGH RISK OF RECURRENCE FOLLOWING PREOPERATIVE THERAPY
Protocol code: WO42633
Sponsor: F. Hoffmann-La Roche AG (Pharmaceutical company). Phase: Therapeutic confirmatory (Phase III). Countries: Greece (ongoing, recruitment ended), Romania (ongoing, recruitment ended), Bulgaria (ongoing, recruitment ended), Spain (ongoing, recruitment ended), France (ongoing, recruitment ended), Czechia (ongoing, recruitment ended), Hungary (ongoing, recruitment ended), Italy (ongoing, recruitment ended), Denmark (ongoing, recruitment ended), Austria (ongoing, recruitment ended), Germany (ongoing, recruitment ended), Portugal (ongoing, recruitment ended), Belgium (ongoing, recruitment ended), Poland (ongoing, recruitment ended).
Therapeutic area(s): Diseases [C] - Neoplasms [C04]
Gender: Female, Male. Age: 18-64 years, 65+ years. Enrolment: 377.
Status: Ongoing, recruitment ended. Start date (EU): 2021-04-13. Decision date: 2024-03-15. Results received: No. Last updated: 2026-03-02.
Decision dates by country: DK: 2024-03-15, BE: 2024-04-02, DE: 2024-03-15, ES: 2024-03-15, PL: 2024-03-25, GR: 2024-04-23, CZ: 2024-03-18, PT: 2024-03-15, AT: 2024-03-19, HU: 2024-03-18, BG: 2024-04-02, IT: 2024-03-19, RO: 2024-03-21, FR: 2024-03-15

Condition(s): Early human epidermal growth factor receptor 2 (HER2) positive breast cancer
Product: Tecentriq 1 200 mg concentrate for solution for infusion, Herceptin 600 mg solution for injection in vial, Kadcyla 160 mg powder for concentrate for solution for infusion., Tecentriq placebo

Primary endpoint: 1. Invasive disease-free survival
Endpoint(s): 1. Invasive disease-free survival including second primary non breast invasive cancer, 2. IDFS, in the PD-L1-positive and the PD-L1-negative population (defined as all randomized patients from the ITT population with a centrally assessed PD-L1-positive [i.e., PD-L1 status of IC1/2/3] or PD-L1-negative status [i.e.,PD-L1 status of IC0] at randomization as per corresponding stratification factors recorded in the IWRS)., 3. Disease-free survival, 4 . Overall survival, 5 . Distant recurrence-free interval, 6. The proportion of patients in each arm with clinically meaningful deterioration in GHS/QoL physical, role, and cognitive function as measured by scales of the European Organisation for Research and Treatment of Cancer quality of life questionnaire for cancer (EORTC QLQ C30), 7. Mean absolute scores and mean change from baseline scores in GHS/QoL, physical, role, and cognitive function, as assessed using the EORTC QLQ C30, 8. Incidence and severity of adverse events, 9. Maximum and minimum serum concentrations for atezolizumab and trastuzumab emtansine, 10. Incidence of antidrug antibodies (ADAs) to atezolizumab and to trastuzumab emtansine at specified timepoints

Source: https://euclinicaltrials.eu/ctis-public/view/2023-503568-18-00